EU clinical trial 2023-505968-11-00: ImmunoTHerapy Adjacent to Cervical CAncer (ITHACA) study: safety, toxicity and immunological effects of peritumorally delivered immunotherapy in early-stage cervical cancer
Protocol code: 14244
Sponsor: Amsterdam UMC (Hospital/Clinic/Other health care facility). Phase: Human Pharmacology (Phase I)- Other. Countries: Netherlands (ended).
Therapeutic area(s): Diseases [C] - Female Urogenital Diseases and Pregnancy Complications [C13]; Diseases [C] - Neoplasms [C04]
Gender: Female. Age: 18-64 years, 65+ years. Enrolment: 30.
Status: Ended. Start date (EU): 2024-10-15. End date (EU): 2026-05-29. Decision date: 2024-02-22. Results received: No. Last updated: 2025-12-16.

Condition(s): Cervical Cancer

Source: https://euclinicaltrials.eu/ctis-public/view/2023-505968-11-00